EU clinical trial 2024-517566-42-00: Evaluation of the safety and efficacy of Continuous Dopaminergic Stimulation by intracerebroventricular administration of anaerobically conserved dopamine in Parkinson's disease at the motor fluctuation stage: Single-center pilot study
Sponsor: Centre Hospitalier Universitaire De Lille, InBrain Pharma (Hospital/Clinic/Other health care facility, Pharmaceutical company). Phase: Phase I and Phase II (Integrated)- First administration to humans. Countries: France (ended).
Therapeutic area(s): Diseases [C] - Nervous System Diseases [C10]
Gender: Female, Male. Age: 18-64 years, 65+ years. Enrolment: 12.
Status: Ended. End date (EU): 2025-10-02. Decision date: 2024-11-14. Results received: No. Last updated: 2025-05-16.

Condition(s): Parkinson's disease

Source: https://euclinicaltrials.eu/ctis-public/view/2024-517566-42-00